EU clinical trial 2024-516527-13-00: Screening for subclinical antibody mediated rejection and efficacy of belatacept in the context of de novo donor specific antibody after kidney transplantation / BEL-AMR
Protocol code: 2022/0342/HP
Sponsor: Centre Hospitalier Universitaire Rouen (Hospital/Clinic/Other health care facility). Phase: Phase III and phase IV (Integrated). Countries: France (authorised, recruiting).
Therapeutic area(s): Diseases [C] - Digestive System Diseases [C06]; Analytical, Diagnostic and Therapeutic Techniques and Equipment [E] - Therapeutics [E02]
Gender: Female, Male. Age: 18-64 years, 65+ years. Enrolment: 290.
Status: Authorised, recruiting. Start date (EU): 2026-05-27. Decision date: 2025-06-24. Results received: No. Last updated: 2025-06-24.

Condition(s): Kidney transplantation
Product: Advagraf 0.5 mg prolonged-release hard capsules, NULOJIX 250 mg powder for concentrate for solution for infusion

Primary endpoint: Proportion in each arm, at 12 months post-V0 (Biopsy), of patients with: - decrease eGFR > 20% at 12 months post-V0 (Biopsy), according to CKD-EPI formula - or bad features on 12-month protocol biopsy: cg > 1 - or chronic active ABMR according Banff 2019 classification, - or < 50 % MFI reduction of DSA, - or proteinuria/creatinuria ratio > 0.5 g/g, - or death, - or graft loss.
Endpoint(s): To compare in both randomized arms: 1) All Banff 2019 elementary lesions of the kidney graft biopsy performed at 12 months after post-V0 (Biopsy), 2) Serum creatinine and calculation of eGFR according to CKD-EPI formula at 12 and 36 months post-V0 (Biopsy), 3) Proteinuria/creatininuria ratio at 12 and 36 months post-V0 (Biopsy), 4) Bad features on 12-month biopsy (cg>1), 5) Biopsy proven acute T cell rejection rate according to Banff 2019 classification, 6) MFI of the DSA at 12 months post randomization with a Luminex single antigen assay and at 36 months post-randomization from medical charts, 7) Adverse events’ collect (Occurrence of BK virus, CMV and EBV’s viremia, cardiovascular events, hospitalizations), 8) Graft loss and death at 12 and 36 months post-V0 (Biopsy) from medical charts, To compare the groups formed at the initial biopsy with respect to: 9) Serum creatinine and calculation of eGFR according CKD-EPI formula, and proteinuria/creatininuria ratio at 12 and 36 months, 10) Graft loss and death at 12 and 36 months from medical charts, 11) Number of patients with sABMR according to Banff 2019 classification on biopsy performed at 12 months as part of routine care or before in the group without sABMR on initial biopsy divided by the time between initial biopsy and the first biopsy showing sABMR

Source: https://euclinicaltrials.eu/ctis-public/view/2024-516527-13-00